EU clinical trial 2023-510238-10-00: A Randomized, Double-Blind, Placebo-Controlled Phase 2a Proof of Concept Study Evaluating the Safety and Efficacy of ADX-914 in Subjects with Moderate to Severe Atopic Dermatitis
Protocol code: ADX-914-202
Sponsor: Q32 Bio Inc. (Pharmaceutical company). Phase: Therapeutic exploratory (Phase II). Countries: Poland (ended).
Therapeutic area(s): Diseases [C] - Skin and Connective Tissue Diseases [C17]
Gender: Female, Male. Age: 18-64 years, 65+ years. Enrolment: 18.
Status: Ended. Start date (EU): 2024-05-13. End date (EU): 2024-12-10. End date: 2024-12-11. Decision date: 2024-04-29. Results received: Yes. Last updated: 2024-12-09.

Condition(s): Moderate to Severe Atopic Dermatitis
Product: Placebo

Primary endpoint: Part A only: Safety parameters including incidence of serious adverse events and adverse events of special interest, Part B only: Mean percentage change from baseline in Eczema Area and Severity Index (EASI) score at Week 14 for ADX-914 (Part B dose selected) vs placebo
Endpoint(s): Mean percentage change from baseline in EASI score at Weeks 4, 8, 12, 16, and 24, Mean percentage change from baseline in Scoring Atopic Dermatitis (SCORAD) score at Weeks 4, 8, 12, 14, 16, and 24, Proportion of subjects achieving EASI 50, 75 and 90 at Weeks 4, 8, 12, 14, 16, and 24, Proportion of subjects achieving Validated Investigator Global Assessment for Atopic Dermatitis (vIGA-AD) score of 0 or 1 with at least 2 grades of reduction from Baseline at Weeks 4, 8, 12, 14, 16, and 24, Part A and B: Safety of ADX-914 in the AD population as evaluated by adverse events (AEs), laboratory evaluations, physical examinations, vital signs, and 12-lead electrocardiogram (ECG)

Source: https://euclinicaltrials.eu/ctis-public/view/2023-510238-10-00